EU clinical trial 2024-517477-24-00: Assessment of Tolerance and Effectiveness of Total Body Irradiation and Cladribine Before Allogeneic Hematopoietic Cell Transplantation in Patients With Acute Myeloid Leukemia and Myelodysplastic Syndromes
Protocol code: 20-NIO-0001
Sponsor: Narodowy Instytut Onkologii Im. Marii Sklodowskiej-Curie Panstwowy Instytut Badawczy (Hospital/Clinic/Other health care facility). Phase: Therapeutic exploratory (Phase II). Countries: Poland (ongoing, recruitment ended).
Therapeutic area(s): Diseases [C] - Neoplasms [C04]
Gender: Female, Male. Age: 18-64 years. Enrolment: 40.
Status: Ongoing, recruitment ended. Start date (EU): 2022-02-17. Decision date: 2024-11-18. Results received: No. Last updated: 2025-04-02.

Condition(s): Acute myeloid leukemia, myelodysplastic syndromes
Product: BIODRIBIN, 1 mg/ml, roztwór do infuzji

Primary endpoint: The probability of progression-free survival in 24 month FU.
Endpoint(s): Frequency of adverse events in 24 month FU., 24-month overall survival probability., Disease recurrence probability., Mortality unrelated with disease recurrence., Likelihood of acute and chronic graft-versus-host disease., Time of neutrophil and platelet implantation.

Source: https://euclinicaltrials.eu/ctis-public/view/2024-517477-24-00